EU clinical trial 2023-508054-25-01: Phase 1 study assessing the pharmacokinetics of NEX-22A in subjects with T2D
Protocol code: NEX-22-01
Sponsor: Nanexa AB (Pharmaceutical company). Phase: Human Pharmacology (Phase I)- Other. Countries: Germany (ended).
Therapeutic area(s): Diseases [C] - Nutritional and Metabolic Diseases [C18]
Gender: Female, Male. Age: 18-64 years, 65+ years. Enrolment: 12.
Status: Ended. Start date (EU): 2025-02-26. End date (EU): 2025-05-05. Decision date: 2024-05-15. Results received: No. Last updated: 2025-01-24.

Condition(s): Type 2 diabetes

Source: https://euclinicaltrials.eu/ctis-public/view/2023-508054-25-01